EU clinical trial 2023-507889-89-00: Randomized, Embedded, Multifactorial Adaptive Platform trial for Community-Acquired Pneumonia
Protocol code: NCT02735707
Sponsor: Universitair Medisch Centrum Utrecht (Hospital/Clinic/Other health care facility). Phase: Therapeutic confirmatory (Phase III). Countries: France (ongoing, recruiting), Romania (ongoing, recruitment ended), Portugal (ongoing, recruitment ended), Italy (ongoing, recruitment ended), Belgium (ongoing, recruiting), Germany (ongoing, recruitment ended), Czechia (ongoing, recruitment ended), Netherlands (ongoing, recruiting), Croatia (ongoing, recruitment ended), Estonia (ongoing, recruitment ended), Ireland (ongoing, recruiting), Spain (ongoing, recruiting), Slovenia (ongoing, recruiting).
Therapeutic area(s): Diseases [C] - Respiratory Tract Diseases [C08]
Gender: Female, Male. Age: 0-17 years, 18-64 years, 65+ years. Enrolment: 3471.
Start date (EU): 2016-02-19. Decision date: 2024-03-20. Results received: No. Last updated: 2026-07-10.
Decision dates by country: DE: 2024-03-22, EE: 2024-03-22, FR: 2024-03-21, BE: 2024-04-03, CZ: 2024-03-20, SI: 2024-03-25, PT: 2024-04-03, ES: 2024-03-21, HR: 2024-03-21, IT: 2024-03-25, RO: 2024-03-22, IE: 2024-03-20, NL: 2024-03-20

Condition(s): Respiratory tract infection
Product: AMOXICILLIN AND BETA-LACTAMASE INHIBITOR, LEVOFLOXACIN, AZITHROMYCIN, CEFTRIAXONE, ERYTHROMYCIN, TOCILIZUMAB, HYDROCORTISONE, BARICITINIB, AZITHROMYCIN, DEXAMETHASONE, PIPERACILLIN AND BETA-LACTAMASE INHIBITOR, DEXAMETHASONE, ERYTHROMYCIN LACTOBIONATE, IMATINIB, OSELTAMIVIR, MOXIFLOXACIN, CLARITHROMYCIN, BALOXAVIR MARBOXIL, CLARITHROMYCIN, ROXITHROMYCIN

Primary endpoint: The primary endpoint, named Survival and Recovery Trajectory, will be a composite of 90-day all-cause mortality and, among survivors, a daily ordinal scale analyzed as a trajectory of illness and recovery to 28 days., This hierarchical ordinal scale is a composite of: • Landmark mortality at Day 90 post-randomization • Among Day-90 survivors, their daily respiratory support level as defined by position on a five-category ordinal scale: • Hospitalized on ECMO or invasive mechanical ventilation. • Hospitalized on non-invasive ventilation or high-flow oxygen. • Hospitalized on low-intensity oxygen. • Hospitalized, no oxygen. • Discharged from index hospitalization
Endpoint(s): The generic key secondary endpoints for the trial are: • Hospital length-of-stay • Mortality censored at 90 days, Domain-specific secondary outcomes (during the index hospitalization, censored 90 days after enrolment)

Source: https://euclinicaltrials.eu/ctis-public/view/2023-507889-89-00